EU clinical trial 2024-515734-32-00: Safety of rotigotine in patients with autosomal dominant polycystic kidney disease - ETERNAL-PKD
Protocol code: 2022/0345/HP
Sponsor: Centre Hospitalier Universitaire Rouen (Hospital/Clinic/Other health care facility). Phase: Therapeutic exploratory (Phase II). Countries: France (ongoing, recruiting).
Therapeutic area(s): Diseases [C] - Digestive System Diseases [C06]; Analytical, Diagnostic and Therapeutic Techniques and Equipment [E] - Therapeutics [E02]
Gender: Female, Male. Age: 18-64 years. Enrolment: 120.
Status: Ongoing, recruiting. Start date (EU): 2026-03-20. Decision date: 2025-01-13. Results received: No. Last updated: 2025-01-13.

Condition(s): Kidney Disease
Product: Neupro 2 mg/24 h transdermal patch, Neupro 4 mg/24 h transdermal patch

Primary endpoint: Safety is defined by the occurrence of adverse reactions (AEs) and the occurrence of serious adverse reactions (SAEs) for 24 months. The main safety criterion is based on the proportion of participants who experienced at least one SAE during the 24 months of study follow-up, such as the occurrence of serious reactions at the application site or certain behavioral disorders.
Endpoint(s): 1.a. Evaluate the change in 24 months in total renal volume measured by height-adjusted MRI 1.b. Evaluate the variation in glomerular filtration rate (GFR) over 24 months estimated by the CKD-EPI formula, 2. Evaluate the variation in blood pressure over 24 months by 24-hour ABPM, 3. Evaluate the change in quality of life over 24 months using the ADPKD-IS (Appendix 2), 4. Evaluate the variation over 24 months in urinary markers of ADPKD progression (copeptin, cAMP, MCP-1, AQP-2), 5) Evaluate treatment compliance over 24 months by calculating the discontinuity rate., 6) Evaluate the proportion of patients who answered yes (and respectively no) to the question: “Would you tolerate this treatment for the rest of your life?” »

Source: https://euclinicaltrials.eu/ctis-public/view/2024-515734-32-00